EU clinical trial 2023-508204-38-00: A Phase 3, Randomized, Open-Label Study of Combination Therapy with Avutometinib plus Defactinib Versus Investigator’s Choice of Treatment in Patients with Recurrent Low-Grade Serous Ovarian Cancer (LGSOC) (RAMP301)
Protocol code: VS-6766-301
Sponsor: Verastem Inc. (Pharmaceutical company). Phase: Therapeutic confirmatory (Phase III). Countries: Spain (ongoing, recruiting), France (ongoing, recruiting), Italy (ongoing, recruiting), Germany (ongoing, recruiting), Belgium (ongoing, recruiting), Ireland (ongoing, recruiting), Netherlands (ongoing, recruiting), Poland (ongoing, recruiting), Denmark (ongoing, recruiting).
Therapeutic area(s): Diseases [C] - Female Urogenital Diseases and Pregnancy Complications [C13]
Gender: Female. Age: 18-64 years, 65+ years. Enrolment: 183.
Status: Ongoing, recruiting. Start date (EU): 2024-07-02. Decision date: 2024-05-22. Results received: No. Last updated: 2026-07-21.
Decision dates by country: BE: 2024-05-22, DK: 2025-04-13, PL: 2025-04-22, ES: 2024-06-07, IT: 2024-05-23, NL: 2025-03-17, DE: 2024-05-23, FR: 2024-05-23, IE: 2025-04-17

Condition(s): Recurrent Low-Grade Serous Ovarian Cancer (LGSOC)
Product: ZOLSKETIL pegylated liposomal 2 mg/mL concentrate for dispersion for infusion, Paclitaxel Ribosepharm 6 mg/ml Konzentrat zur Herstellung einer Infusionslösung, Caelyx pegylated liposomal 2 mg/ml concentrate for solution for infusion, Letrozol STADA® 2,5 mg Filmtabletten, Anastrozol STADA® 1 mg Filmtabletten, VS-6063, Paclitaxel AqVida 6 mg/ml Konzentrat zur Herstellung einer Infusionslösung, LETRO-cell® 2,5 mg Filmtabletten, VS-6766, Topotecan HEXAL 1 mg/ml Konzentrat zur Herstellung einer Infusionslösung, Letrozol - 1 A Pharma® 2,5 mg Filmtabletten, Anastrozol - 1 A Pharma 1 mg Filmtabletten

Primary endpoint: Progression-free survival (PFS) according to Response Evaluation Criteria in Solid Tumors (RECIST) version 1.1, per blinded independent central review (BICR)
Endpoint(s): Unless otherwise specified, all tumor response-based endpoints will be analyzed using both BICR and Investigator assessments. • Overall Survival (OS) • PFS according to RECIST v1.1, per Investigator Assessment • Objective response rate (ORR) • Duration of response (DoR) • Disease control rate (DCR), defined as having achieved a best response of complete response (CR) or partial response (PR), or stable disease (SD) documented at ≥ Week 24

Source: https://euclinicaltrials.eu/ctis-public/view/2023-508204-38-00